EU clinical trial 2024-517980-22-00: A Phase II, Randomized, Open-Label, Parallel Group, Multicenter Study to Assess Bioequivalence of Two Subcutaneous Formulations of Ocrelizumab in Patients with Multiple Sclerosis
Protocol code: CN45320
Sponsor: F. Hoffmann-La Roche AG (Pharmaceutical company). Phase: Therapeutic exploratory (Phase II). Countries: Poland (ongoing, recruitment ended), Italy (ongoing, recruitment ended), France (ongoing, recruitment ended), Spain (ongoing, recruitment ended), Germany (ongoing, recruitment ended).
Therapeutic area(s): Diseases [C] - Nervous System Diseases [C10]; Diseases [C] - Immune System Diseases [C20]
Gender: Female, Male. Age: 18-64 years. Enrolment: 86.
Status: Ongoing, recruitment ended. Start date (EU): 2025-12-10. Decision date: 2025-12-05. Results received: No. Last updated: 2026-06-16.
Decision dates by country: IT: 2025-12-09, PL: 2025-12-09, FR: 2025-12-05, DE: 2026-02-26, ES: 2026-02-25

Condition(s): Multiple Sclerosis (MS)
Product: Ocrevus, Ocrelizumab, Ocrevus, Ocrevus 920 mg solution for injection

Primary endpoint: The primary PK parameters of ocrelizumab: area under the serum concentration−time curve over the first 12 weeks post-dose (AUC0-12W) and maximum serum concentration observed (Cmax)
Endpoint(s): Incidence and severity of adverse events, with severity determined according to the National Cancer Institute Common Terminology Criteria for Adverse Events (NCI CTCAE) v5 grading scale, Change from baseline in selected vital signs, Change from baseline in selected clinical laboratory test results

Source: https://euclinicaltrials.eu/ctis-public/view/2024-517980-22-00